EU clinical trial 2024-519114-31-00: A Phase I, Open-Label Study of CLN-978 in Patients with Treatment-Refractory Rheumatoid Arthritis (RA)
Protocol code: CLN-978-RA-101
Sponsor: Cullinan Therapeutics Inc. (Pharmaceutical company). Phase: Human Pharmacology (Phase I)- Other. Countries: Germany (ongoing, recruiting), Italy (ongoing, recruiting), Poland (authorised, recruitment pending).
Therapeutic area(s): Diseases [C] - Musculoskeletal Diseases [C05]
Gender: Female, Male. Age: 18-64 years, 65+ years. Enrolment: 46.
Start date (EU): 2025-05-15. Decision date: 2025-04-11. Results received: No. Last updated: 2026-05-06.
Decision dates by country: PL: 2026-05-06, DE: 2025-04-11, IT: 2025-04-15

Condition(s): Treatment-Refractory Rheumatoid Arthritis

Source: https://euclinicaltrials.eu/ctis-public/view/2024-519114-31-00